EU clinical trial 2024-518224-74-01: A multicenter, Phase II, open label, randomized trial evaluating the efficacy of Tedopi plus docetaxel or Tedopi plus nivolumab as second-line therapy in metastatic non-small-cell lung cancer progressing after first-line chemo-immunotherapy (Combi-TED)
Protocol code: COMBI-TED
Sponsor: Fondazione Ricerca Traslazionale (Laboratory/Research/Testing facility). Phase: Therapeutic exploratory (Phase II). Countries: Italy (authorised, recruiting), France (authorised, recruiting), Spain (authorised, recruiting).
Therapeutic area(s): Diseases [C] - Neoplasms [C04]
Gender: Female, Male. Age: 18-64 years, 65+ years. Enrolment: 105.
Status: Authorised, recruiting. Start date (EU): 2025-02-07. Decision date: 2025-02-07. Results received: No. Last updated: 2026-05-18.
Decision dates by country: ES: 2025-02-07, FR: 2025-02-13, IT: 2025-02-24

Condition(s): metastatic non-small-cell lung cancer
Product: NIVOLUMAB, TEDOPI

Primary endpoint: 1-year Survival Rate
Endpoint(s): Overall Survival (OS) (1 and 2-year OS), Progression-free survival (PFS) (1 and 2-year PFS), Objective Response rate (ORR), Safety, Correlation of ORR, PFS and OS with tumor biomarkers

Source: https://euclinicaltrials.eu/ctis-public/view/2024-518224-74-01